EU clinical trial 2024-514092-18-00: Oncolytic virus TILT-123 in combination with lymphocyte-depleting chemotherapy and TILs in the treatment of melanoma
Sponsor: TILT Biotherapeutics Oy (Pharmaceutical company). Phase: Human Pharmacology (Phase I)- Other. Countries: Denmark (ongoing, recruiting).
Therapeutic area(s): Diseases [C] - Neoplasms [C04]
Gender: Female, Male. Age: 18-64 years, 65+ years. Enrolment: 9.
Status: Ongoing, recruiting. Start date (EU): 2025-03-31. Decision date: 2024-09-05. Results received: No. Last updated: 2026-02-23.

Condition(s): Melanoma

Source: https://euclinicaltrials.eu/ctis-public/view/2024-514092-18-00